EU clinical trial 2022-503042-42-00: A prospective, multicenter, open-label, single-arm, Phase 2 study to investigate the safety, tolerability and pharmacokinetics of selexipag in children with pulmonary arterial hypertension
Protocol code: AC-065A203
Sponsor: Actelion Pharmaceuticals Ltd. (Pharmaceutical company). Phase: Therapeutic exploratory (Phase II). Countries: Hungary (ongoing, recruitment ended), Germany (ongoing, recruitment ended), France (ongoing, recruitment ended).
Therapeutic area(s): Diseases [C] - Respiratory Tract Diseases [C08]
Gender: Female, Male. Age: 0-17 years. Enrolment: 14.
Status: Ongoing, recruitment ended. Start date (EU): 2018-07-23. Decision date: 2023-08-11. Results received: No. Last updated: 2026-04-02.
Decision dates by country: HU: 2023-08-11, FR: 2023-08-31, DE: 2023-08-15

Condition(s): Pulmonary Arterial Hypertension
Product: JNJ-67896049, JNJ-67896049

Primary endpoint: Primary pharmacokinetic (PK) endpoint: - Model-based exposure (AUCτ,ss, combined) of selexipag and ACT- 333679 corrected for their potency, determined during the 12 weeks up- titration period

Source: https://euclinicaltrials.eu/ctis-public/view/2022-503042-42-00